EU clinical trial 2024-518680-36-00: EvaluatioN of High-Intensity Focused Ultrasound (HIFU) Hemi-ablation and short-term AndrogeN deprivation therapy Combination to Enhance prostate control for intermediate risk localized prostate cancer: the ENHANCE prospective feasibility trial
Protocol code: ENHANCE
Sponsor: Institut Mutualiste Montsouris (Hospital/Clinic/Other health care facility). Phase: Therapeutic exploratory (Phase II). Countries: France (ended).
Therapeutic area(s): Diseases [C] - Neoplasms [C04]
Gender: Male. Age: 18-64 years, 65+ years. Enrolment: 20.
Status: Ended. Start date (EU): 2023-03-07. End date (EU): 2026-07-06. Decision date: 2024-10-25. Results received: No. Last updated: 2024-10-25.

Condition(s): Intermediate risk prostate cancer
Product: ELIGARD 22,5 mg, poudre et solvant pour solution injectable

Primary endpoint: Proportion of treatment failure 12 months after HIFU treatment, identified as men harbouring clinically significant prostate cancer in treated and/or untreated areas of the prostate
Endpoint(s): Biological results: serum PSA and testosterone levels at 1, 3, 6 and 12 months post-treatment, Erectile function : IIEF-5 score changes at differrent time ponts post-treatment, as comared to baseline, proportion of men cho are potent at baseline and then sustain erectile dysfunction, Ejaculatory function: MSHQ-EjD score changes at different time points post-treatment as compared to baseline, Continence at 1, 3, 6 and 12 months post-treatment as compared to baseline : changes of ICSmaleIS score, at differrent time points post-treatment; proportion of continent men, Voiding function at 1, 3, 6 and 12 months post-treatment: changes of IPSS score at different time points post-treatment as compared to baseline, Quality of life at 1, 3, 6 and 12 months post-treatment: changes of the EQ-5D-5L score at different time points post-treatment, Complications / treatment-related toxicity, Secondary intervention : proportion of men requiring salvage secondary prostate cancer intervention due to treatment failure

Source: https://euclinicaltrials.eu/ctis-public/view/2024-518680-36-00